EU clinical trial 2024-510898-24-00: An Italian multicenter phase II trial of Metronomic Temozolomide in unfit patients with advanced neuroendocrine neoplasms (NENs): MeTe study
Protocol code: IEO 1411
Sponsor: Istituto Europeo Di Oncologia S.r.l. (Hospital/Clinic/Other health care facility). Phase: Therapeutic exploratory (Phase II). Countries: Italy (ongoing, recruitment ended).
Therapeutic area(s): Diseases [C] - Neoplasms [C04]
Gender: Female, Male. Age: 18-64 years, 65+ years. Enrolment: 46.
Status: Ongoing, recruitment ended. Start date (EU): 2022-01-14. Decision date: 2024-03-11. Results received: No. Last updated: 2024-11-27.

Condition(s): Patients with well differentiated neuroendocrine neoplasia (NENs) not eligible for active antitumoral treatments due to their clinical conditions.
Product: TEMOZOLOMIDE

Primary endpoint: Progression free survival (PFS)
Endpoint(s): Objective response rate (ORR) that means complete response (CR) + partial response (PR) in progressive, metastatic, low grade NENs, Duration of response, Overall survival (OS)., Safety, Quality of life (QoL), Centralized evaluation of O6-methylguanine-DNA-methyltransferase (MGMT) status in tumor tissue to correlate clinical outcomes and MGMT status and validate the method of MGMT determination

Source: https://euclinicaltrials.eu/ctis-public/view/2024-510898-24-00